EU clinical trial 2024-520384-14-00: A randomised, double-masked, placebo-controlled trial to evaluate the efficacy, safety, and tolerability of oral BI 1815368 in participants with centre-involved diabetic macular edema for 48 weeks of treatment (THULITE)
Protocol code: 1485-0018
Sponsor: Boehringer Ingelheim International GmbH (Pharmaceutical company). Phase: Therapeutic exploratory (Phase II). Countries: Germany (ongoing, recruiting), Slovakia (ongoing, recruiting), Poland (ongoing, recruiting), Hungary (ongoing, recruiting), Czechia (ongoing, recruiting).
Therapeutic area(s): Diseases [C] - Eye Diseases [C11]
Gender: Female, Male. Age: 18-64 years, 65+ years. Enrolment: 193.
Status: Ongoing, recruiting. Start date (EU): 2025-11-20. Decision date: 2025-09-30. Results received: No. Last updated: 2026-05-25.
Decision dates by country: CZ: 2025-10-01, DE: 2025-10-01, HU: 2025-10-03, PL: 2025-10-06, SK: 2025-09-30

Condition(s): Centre-involved diabetic macular edema
Product: BI 1815368, BI 1815368 Placebo, BI 1815368

Primary endpoint: Occurrence (yes/no) of a gain of ≥10 ETDRS letters compared with baseline in the study eye at Week 48
Endpoint(s): Occurrence (yes/no) of gain of ≥15 ETDRS letters compared with baseline in the study eye at Week 48, Occurrence (yes/no) of drug-related AEs over the treatment period through EoS, Absolute change from baseline of CST as measured by SD-OCT in the study eye at Week 48

Source: https://euclinicaltrials.eu/ctis-public/view/2024-520384-14-00